EU clinical trial 2024-511246-39-00: Beamion LUNG-1: A study to test different doses of zongertinib in people with different types of advanced cancer (solid tumours with changes in the HER2 gene)
Protocol code: 1479-0001
Sponsor: Boehringer Ingelheim International GmbH, Boehringer Ingelheim Espana S.A. (Pharmaceutical company). Phase: Human Pharmacology (Phase I)- First administration to humans. Countries: Spain (ongoing, recruitment ended), Netherlands (ongoing, recruitment ended), Belgium (ongoing, recruitment ended), Germany (ongoing, recruitment ended), Sweden (ended), Portugal (ended), Italy (ended), France (ongoing, recruitment ended).
Therapeutic area(s): Diseases [C] - Neoplasms [C04]
Gender: Female, Male. Age: 18-64 years, 65+ years. Enrolment: 162.
Start date (EU): 2021-07-27. Decision date: 2024-09-25. Results received: No. Last updated: 2026-05-20.
Decision dates by country: IT: 2024-10-14, BE: 2024-09-26, SE: 2024-09-27, PT: 2024-10-07, DE: 2024-09-26, FR: 2024-10-17, ES: 2024-09-25, NL: 2024-09-26

Condition(s): Solid tumours with HER2 aberrations, Non-small cell lung cancer

Source: https://euclinicaltrials.eu/ctis-public/view/2024-511246-39-00